EU clinical trial 2025-521172-64-00: Comparative, randomized, open, crossover clinical trial to investigate adhesiveness of a newly developed Rotigotine 12 mg/24 h transdermal patch in patients with Parkinson’s disease
Protocol code: 1462rot25ct
Sponsor: Luye Pharma Switzerland AG (Pharmaceutical company). Phase: Therapeutic exploratory (Phase II). Countries: Germany (ended).
Therapeutic area(s): Diseases [C] - Nervous System Diseases [C10]
Gender: Female, Male. Age: 18-64 years, 65+ years. Enrolment: 24.
Status: Ended. Start date (EU): 2026-01-05. End date (EU): 2026-03-06. Decision date: 2025-07-23. Results received: No. Last updated: 2025-12-04.

Condition(s): Parkinson's disease
Product: ROT-TDS, Neupro 8 mg/24 h transdermal patch, Neupro 8 mg/24 h transdermal patch

Primary endpoint: Mean adhesion of Test at 23 h 55 min, Difference of adhesiveness (Test – Reference) at 23 h 55 min
Endpoint(s): Frequency of AESIs, Frequency of AEs

Source: https://euclinicaltrials.eu/ctis-public/view/2025-521172-64-00